EU clinical trial 2024-518764-13-00: A Phase I, randomized, controlled, Latin-square, open-label study, to evaluate the effect of ADV7103 on gastric pH under fed and fasting conditions in adult healthy participants.
Protocol code: B06CS
Sponsor: Advicenne (Pharmaceutical company). Phase: Human Pharmacology (Phase I)- Other. Countries: France (ended).
Therapeutic area(s): Diseases [C] - Male Urogenital Diseases [C12]; Diseases [C] - Female Urogenital Diseases and Pregnancy Complications [C13]
Gender: Female, Male. Age: 18-64 years. Enrolment: 12.
Status: Ended. Start date (EU): 2025-02-25. End date (EU): 2025-03-18. Decision date: 2025-02-19. Results received: No. Last updated: 2025-02-19.

Condition(s): distal renal tubular acidosis (dRTA)

Source: https://euclinicaltrials.eu/ctis-public/view/2024-518764-13-00